EU clinical trial 2023-504229-37-00: Hypoxic ventilatory response (HVR): Effect of Esketamine
Sponsor: Leiden University Medical Center (Hospital/Clinic/Other health care facility). Phase: Therapeutic use (Phase IV). Countries: Netherlands (ended).
Therapeutic area(s): Phenomena and Processes [G] - Physiological processes [G07]
Gender: Female, Male. Age: 18-64 years. Enrolment: 18.
Status: Ended. Start date (EU): 2023-08-04. End date (EU): 2025-03-14. Decision date: 2023-06-12. Results received: Yes. Last updated: 2023-06-12.

Condition(s): healthy volunteers
Product: Remifentanil-hameln 1 mg, poeder voor concentraat voor oplossing voor injectie of infusie, normal saline 0.9% NaCl, Naloxon Orpha 0,4 mg/ml, oplossing voor injectie of infusie, Ketanest-S® 5, oplossing voor injectie 5 mg/ml

Primary endpoint: Hypoxic ventilatory response
Endpoint(s): Psychomimetic side effects at the end of a hypoxic episode., Esketamine plasma concentrations

Source: https://euclinicaltrials.eu/ctis-public/view/2023-504229-37-00